EU clinical trial 2024-516541-40-00: Interest of belatacept as a non-nephrotoxic immunosuppressive treatment in cardiac transplant patients at risk of chronic renal failure.
Protocol code: RC19_0133
Sponsor: Centre Hospitalier Universitaire De Nantes (Hospital/Clinic/Other health care facility). Phase: Therapeutic exploratory (Phase II). Countries: France (authorised, recruiting).
Therapeutic area(s): Diseases [C] - Pathological Conditions, Signs and Symptoms [C23]
Gender: Female, Male. Age: 18-64 years, 65+ years. Enrolment: 25.
Status: Authorised, recruiting. Start date (EU): 2024-09-04. Decision date: 2024-09-04. Results received: No. Last updated: 2026-01-07.

Condition(s): Early graft dysfunction after heart transplant
Product: PROGRAF 5 mg capsule, Neoral 100 mg Soft Capsules, Advagraf 5 mg prolonged-release hard capsules, NULOJIX 250 mg powder for concentrate for solution for infusion

Primary endpoint: Determination of plasma creatinine and calculation of clearance according to the formula CKD EPI at M3 and M12 post HT.
Endpoint(s): - Myocardial biopsies between M3 and M12 post HT, - Anti-HLA antibody testing according to the habits of heart transplant centres, - Fasting blood glucose and HBA1C at M3 and M12 post HT, - Death, - Number of dialysis sessions between M3 and M12 post HT

Source: https://euclinicaltrials.eu/ctis-public/view/2024-516541-40-00